EU clinical trial 2025-521350-41-01: A confirmatory, randomized, placebo-controlled, double-blind, multicenter trial to assess the efficacy of CEREBROLYSIN in post-acute ischemic stroke recovery (CARS-CT)
Protocol code: FSNANO28012025
Sponsor: Foundation For The Study Of Nanoneuroscience And Neuroregeneration (Laboratory/Research/Testing facility). Phase: Therapeutic confirmatory (Phase III). Countries: Romania (ongoing, recruiting).
Therapeutic area(s): Diseases [C] - Nervous System Diseases [C10]
Gender: Female, Male. Age: 18-64 years, 65+ years. Enrolment: 416.
Status: Ongoing, recruiting. Start date (EU): 2025-10-10. Decision date: 2025-07-07. Results received: No. Last updated: 2025-08-21.

Condition(s): Stroke
Product: CEREBROLYSIN, Ser fiziologic 90 mg/10 ml solvent pentru uz parenteral

Primary endpoint: Action Reasearch Arm Test (ARAT)
Endpoint(s): NIH Stroke Scale (NIH), Modified Rankin Scale (mRS), Barthel Index, Hospital Anxiety and Depression Scale (HADS), EQ-5D-5L

Source: https://euclinicaltrials.eu/ctis-public/view/2025-521350-41-01